EU clinical trial 2024-516689-13-00: A Phase 1b/2 Trial Evaluating the Safety, Pharmacokinetics, and Efficacy of EP 104GI in Adults with Eosinophilic Esophagitis (RESOLVE)
Protocol code: EP-104IAR-102
Sponsor: Eupraxia Pharmaceuticals Inc. (Pharmaceutical company). Phase: Phase I and Phase II (Integrated)- Other. Countries: Netherlands (ongoing, recruiting).
Therapeutic area(s): Diseases [C] - Digestive System Diseases [C06]; Diseases [C] - Immune System Diseases [C20]
Gender: Female, Male. Age: 18-64 years, 65+ years. Enrolment: 5.
Status: Ongoing, recruiting. Start date (EU): 2023-02-06. Decision date: 2024-09-11. Results received: No. Last updated: 2026-06-17.

Condition(s): Eosinophilic esophagitis
Product: TETRACOSACTIDE, EP-104GI

Primary endpoint: Frequency and severity of treatment-emergent adverse events (TEAEs), Change from baseline in clinical safety laboratory measurements, Change from baseline in morning serum cortisol levels on Day 1 postdose and timepoints up to 52 Weeks postdose, Change from baseline in vital signs at 1 and 24 hours postdose and timepoints up to 52 Weeks postdose., Plasma concentrations of FP, measured at baseline (predose), 2 and 24 hours postdose, and timepoints up to 108 Weeks postdose (dependent on the portion of the study participated in)
Endpoint(s): Change from baseline in EoE Histology Scoring System (EoEHSS) grade and stage scores at timepoints up to 52 Weeks postdose, Histological response mapped over the surface of the esophagus as a function of proximity to, and size of dose, measured by peak eosinophil count (PEC) at timepoints up to 52 Weeks postdose, Change from baseline in the EoE Endoscopic Reference Score (EREFS) at timepoints up to 52 Weeks postdose, Change from baseline in the Straumann Dysphagia Index (SDI) patient reported outcome (PRO) score at timepoints up to 52 Weeks postdose, Change from baseline in the Dysphagia symptom questionnaire (DSQ) v4.0 and "Dysphagia days" at timepoints up to 52 Weeks postdose (Phase 2; randomized portion of the study only), Change from baseline in Patient Global Impression of Change and Patient Global Impression of Severity (PGIC/PGIS) at timepoints up to 52 Weeks postdose (Phase 2; randomized portion of the study only), Change from baseline in dysphagia measured on an 11 point Likert scale at timepoints up to 52 Weeks postdose, Change from baseline in odynophagia measured on an 11 point Likert scale at timepoints up to 52 Weeks postdose, Change from baseline in the Eosinophilic Esophagitis Impact Questionnaire (EOE-IQ) at timepoints up to 52 Weeks postdose (Phase 2; randomized portion of the study only)

Source: https://euclinicaltrials.eu/ctis-public/view/2024-516689-13-00